EU clinical trial 2025-522052-13-00: Framework for Optimizing, Refining, and Unifying Management of HSCT in Pediatric ALL.
Protocol code: FORUM2
Sponsor: Ospedale Pediatrico Bambino Gesu (Hospital/Clinic/Other health care facility). Phase: Phase II and Phase III (Integrated). Countries: Germany (authorised, recruitment pending), Denmark (authorised, recruitment pending), Finland (authorised, recruitment pending), Norway (authorised, recruitment pending), Austria (authorised, recruitment pending), Italy (ongoing, recruiting), Poland (authorised, recruitment pending), France (authorised, recruitment pending), Czechia (authorised, recruitment pending), Hungary (authorised, recruitment pending).
Therapeutic area(s): Diseases [C] - Hemic and Lymphatic Diseases [C15]
Gender: Female, Male. Age: 0-17 years, 18-64 years. Enrolment: 765.
Start date (EU): 2025-12-24. Decision date: 2025-11-17. Results received: No. Last updated: 2026-07-30.
Decision dates by country: AT: 2025-11-17, CZ: 2025-11-18, DK: 2025-11-18, FI: 2025-11-17, FR: 2025-11-24, IT: 2025-11-17, NO: 2025-11-21, PL: 2025-11-21, DE: 2025-11-18, HU: 2026-07-30

Condition(s): Framework for Optimizing, Refining, and Unifying Management of HSCT in Pediatric ALL
Product: Grafalon 20 mg/ml concentrate for solution for infusion., Trecondi 1 g powder for solution for infusion, Fludarabine 50mg Powder For Solution For Injection Or Infusion, ETOPOSIDE TEVA 100 mg/5 ml, solution injectable pour perfusion, Busulfan Tillomed 6 mg/ml concentrate for solution for infusion, Cyclophosphamide 500 mg Powder for Solution for Injection or Infusion, METHYLPREDNISOLONE, BLINCYTO 38.5 micrograms powder for concentrate and solution for solution for infusion, Thymoglobuline 25 mg powder for solution for infusion., Jakavi 5 mg/ml oral solution, Thiotepa Riemser 100 mg powder for concentrate for solution for infusion, Jakavi 5 mg tablets

Primary endpoint: R1 Sub-Study: The primary endpoint is Event Free Survival (EFS) at year 4. EFS is defined as the time from randomization (intention-to-treat analysis) or HSCT (per-protocol/as treated) to first failure event defined as follows: Failure events are: • Relapse • Death from any cause • Diagnosis of a second malignant neoplasm Patients without event will be censored at last follow-up date., R2 Sub-Study: • Overall response rate (ORR) at Day 28 after randomization, defined as the proportion of patients in each arm demonstrating a complete response (CR) or partial response (PR) without requirement for additional systemic therapies for earlier progression, mixed response or nonresponse. Scoring of response will be relative to the organ stage at the time of randomization., S1 Sub-Study: EFS is defined as the time from HSCT to first failure event defined as follows: Failure events are: - Relapse - Graft failure - Death from any cause - Diagnosis of a second malignant neoplasm Patients without event will be censored at last follow-up date., P1 Sub-Study: Compare the CIR 2 years after HSCT in blinatumomab-treated patents and historical controls. CIR is calculated from the time of study enrolment until the date of relapse (defined as either bone marrow aspirate or biopsy with ≥ 5% blasts or as appearance of leukemia cells in an extramedullary site) or last follow-up (death from any cause other than leukemia relapse will be considered a competing event).

Source: https://euclinicaltrials.eu/ctis-public/view/2025-522052-13-00